EU clinical trial 2023-506723-28-00: A Multi-Center, Randomized, Single-Blind, Placebo-Controlled Study to Assess the Efficacy, Safety, Tolerability, Pharmacokinetics and Pharmacodynamics of Oral TTI-0102 for Treatment of Patients with Mitochondrial encephalomyopathy, lactic acidosis and strokelike episodes (MELAS).
Protocol code: TTI-MITO-001
Sponsor: Thiogenesis Therapeutics (Pharmaceutical company). Phase: Therapeutic exploratory (Phase II). Countries: France (ended), Netherlands (ended).
Therapeutic area(s): Diseases [C] - Musculoskeletal Diseases [C05]; Diseases [C] - Congenital, Hereditary, and Neonatal Diseases and Abnormalities [C16]; Diseases [C] - Nutritional and Metabolic Diseases [C18]; Diseases [C] - Nervous System Diseases [C10]
Gender: Female, Male. Age: 0-17 years, 18-64 years. Enrolment: 12.
Status: Ended. Start date (EU): 2025-03-20. End date (EU): 2026-01-12. Decision date: 2024-12-09. Results received: Yes. Last updated: 2025-09-22.
Decision dates by country: NL: 2024-12-19, FR: 2024-12-09

Condition(s): Mitochondrial encephalomyopathy, lactic acidosis and stroke-like episodes (MELAS)
Product: TTI-0102, Pearlitol® 100 SD (mannitol)

Primary endpoint: The primary outcome measure will be “change in functional capacity” based upon the 12-minute walking test (12-MWT) from Day 1/Baseline to Week 24/Study Exit, Safety and tolerability endpoints include the incidence, severity and relationship of adverse events; change in clinical laboratory parameters, physical exam findings, vital signs, 12-lead electrocardiography and seizure activity.
Endpoint(s): Efficacy: Change over time as measured at Day 1/Baseline, Weeks 4, 8, 12, 16, 20 and Week 24/Study Exit: - Fatigue Severity Scale (FSS); - Quality of Life (WHOQOL-BREF), PK parameters will be determined for cysteamine, pantothenic acid (vitamin B5) and taurine, PD: Change over time as measured at Day 1/Baseline, Weeks 4, 8, 12, 16, 20 and Week 24/Study Exit for pharmacodynamic biomarkers: glutathione, glutathione disulfide, lactate, pyruvate, GDF-15, FGF21, amino acid panel (including alanine).

Source: https://euclinicaltrials.eu/ctis-public/view/2023-506723-28-00